EU clinical trial 2022-502534-23-00: A Phase 1, open-label, single-center study to determine the absorption, distribution, metabolism, and excretion of a single oral dose of SAR443820 containing microtracer [14C]-SAR443820 in healthy male participants
Protocol code: BEX17501
Sponsor: Sanofi-Aventis Research & Development (Pharmaceutical company). Phase: Phase I and Phase II (Integrated)- Other. Countries: Netherlands (ended).
Therapeutic area(s): Diseases [C] - Nervous System Diseases [C10]
Gender: Male. Age: 18-64 years. Enrolment: 6.
Status: Ended. Start date (EU): 2023-06-02. End date (EU): 2023-07-17. Decision date: 2023-05-02. Results received: Yes. Last updated: 2023-06-07.

Condition(s): amyotrophic lateral sclerosis (ALS)
Product: SAR443820

Primary endpoint: Pharmacokinetics Pharmacokinetic data will be summarized using descriptive statistics for each appropriate matrix. The results of other primary endpoint analyses of plasma and excreta samples collected to determine the metabolic pathways of SAR443820 and identify the chemical structures and main excretion routes of the main metabolites will be documented separately.
Endpoint(s): Safety analysis (adverse events [AEs], laboratory parameters, vital signs, and electrocardiograms [ECGs]) will be based on the review of individual values and descriptive statistics.

Source: https://euclinicaltrials.eu/ctis-public/view/2022-502534-23-00